EU clinical trial 2025-525068-13-00: Albuminuria Reduction Trial and Investigation with Survodutide Treatment in CKD (ARTIST-CKD)
Protocol code: 22774
Sponsor: Universitair Medisch Centrum Groningen (Hospital/Clinic/Other health care facility). Phase: Therapeutic exploratory (Phase II). Countries: Germany (authorised, recruitment pending), Spain (authorised, recruitment pending), Netherlands (authorised, recruitment pending).
Therapeutic area(s): Diseases [C] - Nutritional and Metabolic Diseases [C18]
Gender: Female, Male. Age: 18-64 years, 65+ years. Enrolment: 95.
Status: Authorised, recruitment pending. Decision date: 2026-04-21. Results received: No. Last updated: 2026-05-19.
Decision dates by country: DE: 2026-04-22, NL: 2026-05-12, ES: 2026-05-19

Condition(s): Chronic Kidney Disease
Product: Matching placebo for Survodutide, BI 456906, BI 456906, BI 456906, BI 456906, BI 456906

Primary endpoint: Percentage change from baseline to week 32/36 in first morning void UACR
Endpoint(s): Change from baseline to week 36 in eGFR (creatinine, cystatin C, and creatinine-cystatin C), Change from baseline to week 36 in Iohexol measured GFR (subset of 60 participants), Change in UACR and eGFR during 4-week wash-out from week 36 to 40, Change from baseline to week 36 in Perirenal and renal sinus fat measured by MRI (same subset of 60 participants with Iohexol GFR), Change from baseline to week 36 in Subcutaneous and visceral fat assessed by MRI (same subset of 60 participants with Iohexol GFR), Change from baseline to week 36 in Body weight, Change from baseline to week 36 in Waist circumference, Change from baseline to week 36 in Systolic and diastolic blood pressure

Source: https://euclinicaltrials.eu/ctis-public/view/2025-525068-13-00